EU clinical trial 2025-524163-21-00: A randomized, double-blind, placebo-controlled trial of semaglutide for reducing cannabis use in adults with cannabis use disorder
Sponsor: Region Hovedstaden (Hospital/Clinic/Other health care facility). Phase: Therapeutic exploratory (Phase II). Countries: Denmark (ongoing, recruiting).
Therapeutic area(s): Psychiatry and Psychology [F] - Behavior and Behavior Mechanisms [F01]
Gender: Female, Male. Age: 18-64 years, 65+ years. Enrolment: 100.
Status: Ongoing, recruiting. Start date (EU): 2026-05-08. Decision date: 2026-03-30. Results received: No. Last updated: 2026-03-30.

Condition(s): Cannabis dependence (Cannabis Use Disorder or CUD)
Product: Saline Solution Basi 9 mg/ml solution for infusion, Wegovy 0.25 mg solution for injection in pre-filled pen, Wegovy 1 mg solution for injection in pre-filled pen, Wegovy 0.5 mg solution for injection in pre-filled pen, Wegovy 2.4 mg solution for injection in pre-filled pen, Wegovy 1.7 mg solution for injection in pre-filled pen

Primary endpoint: Reduction in total cannabis intake (grams) over the last 28 days, measured using the TLFB after 20 weeks of treatment and adjusted for baseline.
Endpoint(s): Change in plasma and urine concentrations of Δ9-THC and its metabolites (including THC-COOH) from baseline to week 20., Change in Cannabis-free days over the past 28 days, assessed using self-reported TLFB From baseline to week 20., Change in total THC consumption, measured in standard THC units over the past 28 days and assessed using the Enhanced Cannabis Timeline Follow-Back (EC-TLFB), adjusted for baseline, from baseline to Week 20. (Total THC consumption is calculated based on grams used, method of administration, and average THC concentration from seized cannabis in Denmark.), Change in Cannabis Use Disorder Identification Test – Revised (CUDIT-R) score from baseline to Week 20., Change in Marijuana Problem Scale (MPS) score from baseline to Week 20., Change in Marijuana Craving Questionnaire – Short Form (MCQ-SF) score from baseline to Week 20., Change in Patient Health Questionnaire-9 (PHQ-9) score from baseline to Week 20., Change in Pittsburgh Sleep Quality Index (PSQI) score from baseline to Week 20., Change in Alcohol Use Disorders Identification Test (AUDIT) score from baseline to Week 20., Change in Drug Use Disorders Identification Test (DUDIT/DUDIT-ED) score from baseline to Week 20., Change in Fagerström Test for Nicotine Dependence score from baseline to Week 20., Change in mean number of cigarettes smoked per day, averaged over the past week, from baseline to Week 20., Change in World Health Organization Quality of Life – BREF (WHOQOL-BREF) score from baseline to Week 20., Percent change in body weight from baseline to Week 20., Change in waist circumference (cm) from baseline to Week 20., Change in blood cotinine levels from baseline to Week 20., Change in blood pressure and pulse from baseline to Week 20., Change in HbA1c from baseline to Week 20., Change in fMRI cue reactivity, assessed using the task described by Karoly et al., from baseline to Week 20., Change in resting-state fMRI connectivity from baseline to Week 20.

Source: https://euclinicaltrials.eu/ctis-public/view/2025-524163-21-00